EU clinical trial 2024-518053-42-00: Short-term effectiveness of Gabapentin versus Placebo in acute Lumbosacral Radiculalgia by herniation disc: a prospective, multicentric, randomized, controlled, double-blind study (GRADE)
Protocol code: RC-P0103
Sponsor: Groupement Des Hopitaux De L'Institut Catholique De Lille (Hospital/Clinic/Other health care facility). Phase: Therapeutic use (Phase IV). Countries: France (ended).
Therapeutic area(s): Diseases [C] - Nervous System Diseases [C10]
Gender: Female, Male. Age: 18-64 years, 65+ years. Enrolment: 144.
Status: Ended. Start date (EU): 2022-02-09. End date (EU): 2024-12-09. Decision date: 2024-10-10. Results received: Yes. Last updated: 2024-10-10.

Condition(s): lumbosacral radiculalgia
Product: Microcrystalline cellulose, GABAPENTINE BIOGARAN 300 mg, gélule

Primary endpoint: Change in radiculalgia Visual Analogue Scale (VAS) between D1 and D4, D1 corresponding to the 1st dose of treatment administered (Gabapentin or Placebo). In addition, the responder rate at D4 (= radiculalgia pain VAS < 40/100) will also be calculated, but only the change in radiculalgia VAS will be used to conclude on the efficacy of the 2 treatments (Gabapentin or Placebo).
Endpoint(s): Rate of patients presenting at least one adverse event (all types and grades) between D1 and D7: According to National Cancer Institute Common terminology criteria for adverse events (NCI CTCAE) v4.0, Change in VAS for low back pain between D1 and D4, and responder rate at D4 (= VAS for low back pain < 40/100), Change in radiculalgia VAS and low back pain VAS between Day 1 and Day 7 (time interval including Day 2, Day 3 and Day 4), Change in NPSI (Neuropathic Pain Symptom Inventory) between Day 1 and Day 4, then between Day 1 and Day 7, Change in radiculalgia VAS between Day 1 and Day 4, and again between Day 1 and Day 7, depending on the initial positivity of the dn4 (neuropathic pain screening questionnaire)., Number of interdoses of anti-nociceptive analgesics between Day 1 and Day 4 and rate of patients using at least one interdose between Day 1 and Day 4., Rate of patients who reduced the associated anti-nociceptive analgesic treatment (reduction in dosage or step or discontinuation) between Day 4 and Day 7., Links between consumption of antidepressants and antiepileptics (yes/no), and radiculalgia pain VAS at D4, if numbers permit in the Gabapentin group.

Source: https://euclinicaltrials.eu/ctis-public/view/2024-518053-42-00